EU clinical trial 2024-517303-36-00: Anti-CD 19 CAR-T cell therapy in patients with ANCA Vasculitis: A two-stage interventional, prospective, open-label, phase I/II trial in patients with active, treatment refractory, ANCA-IgG-positive vasculitis
Protocol code: CCM-RNT-202402
Sponsor: Charite Universitaetsmedizin Berlin KöR (Hospital/Clinic/Other health care facility). Phase: Phase I and Phase II (Integrated)- Other. Countries: Germany (authorised, recruitment pending).
Therapeutic area(s): Diseases [C] - Immune System Diseases [C20]; Diseases [C] - Musculoskeletal Diseases [C05]
Gender: Female, Male. Age: 18-64 years, 65+ years. Enrolment: 8.
Status: Authorised, recruitment pending. Decision date: 2024-12-09. Results received: No. Last updated: 2024-12-09.

Condition(s): ANCA-IgG-positive ANCA associated vasculitis
Product: KYV-101, Fludarabinphosphat-GRY® 25 mg/ml Konzentrat zur Herstellung einer Injektionslösung oder Infusionslösung, ENDOXAN Lyophilisat 2 g Pulver zur Herstellung einer Injektionslösung

Primary endpoint: Safety (Phase I): Incidence and grading of severity (graded 0-4) of Cytokine Release Syndrome (CRS) and of Immune Cell Associated Neurotoxicity Syndrome (ICANS) within the first 4 weeks after anti-CD19 CAR T cell therapy. AE and SAE due to IMP within the first 4 weeks., Safety (Phase II): AE and SAE due to IMP throughout the whole study. All subjects will enter in an obligatory follow-up phase for evaluation of long-term safety lasting 15 years in total. Data will be registered in the EBMT registry after informed consent is obtained from the patients., Efficacy (Phase II): Percentage of AAV subjects (GPA) with normal anti-PR3 antibodies (< 20 AU/ml) and AAV subjects (MPA) with normal anti-MPO antibodies (< 10 AU/ml) at week 24.
Endpoint(s): Survival time without immunosuppression from week 9 to week 52, Time to relapse/flare from week 9 to week 52, Percentage of patients who reach EULAR response criteria (≥ 50% reduction of Birmingham Vasculitis Activity Score (BVAS) at week 12, 24 and 52) compared to baseline, Percentage of patients who reach EULAR sustained remission criteria (Absence of typical signs, symptoms, or other features of active AAV) through week 52, Change of Vasculitis Damage Index (VDI) at week 12, 24 and 52 compared to baseline, Change in Birmingham Vasculitis Activity Score (BVAS) at week 12, 24 and 52 compared to baseline, Number of flares through week 12, 24 and 52 weeks, Percentage of subjects with normal anti-PR3 antibodies (< 20 U/ml) at week 12 and 52 (GPA)., Percentage of subjects with normal anti-MPO antibodies (< 10 U/ml) at week 12 and 52 (MPA)., Duration of persistence of CAR T cells in the peripheral blood, Duration of B cell depletion in the peripheral blood, Expansion of CAR T cells in the patient over time, Change in anti-PR3 antibodies over time (GPA), Change in anti-MPO antibodies over time (MPA), Change in total IgG, IgG subclasses and IgA, IgM immunoglobulins over time, Change in MPO (MPA) or PR3 (GPA) specific plasmablasts and B-cells, Change in the number of plasmablasts, B cell and T cell numbers over time, Patient’s Global Assessment (PtGA) of disease activity (VAS 0-100mm), Physician’s Global Assessment (PhGA) of disease activity (VAS 0-100mm), European Quality of Life 5 Dimensions (EQ-5D), Short Form 36 (SF-36, quality of life questionnaire), ANCA-associated vasculitis patient reported outcome (AAV-PRO), To analyze the changes in B cell receptor repertoire, To evaluate the therapy-induced changes of B cell subsets, Characterizing B Cell and Plasma Cell Niches in Tissues, To evaluate the therapy-induced alterations of T cell compartments, To evaluate changes in kidney biopsy from baseline to week 52 (optional)

Source: https://euclinicaltrials.eu/ctis-public/view/2024-517303-36-00